EU clinical trial 2024-511628-16-00: Randomized adaptive assessment of post COVID syndrome treatments (RAPID) Reducing Inflammatory Activity in Patients with post COVID Syndrome (REVIVE)
Protocol code: 2023-02978
Sponsor: Goethe University Frankfurt (Educational Institution). Phase: Therapeutic exploratory (Phase II). Countries: Germany (ended).
Therapeutic area(s): Diseases [C] - Respiratory Tract Diseases [C08]; Diseases [C] - Virus Diseases [C02]
Gender: Female, Male. Age: 18-64 years, 65+ years. Enrolment: 376.
Status: Ended. Start date (EU): 2024-07-18. End date (EU): 2025-09-30. Decision date: 2024-05-31. Results received: No. Last updated: 2025-05-09.

Condition(s): Post Covid Syndrome (PCS)
Product: The placebo tablets contain mycrocrystalline cellulose as a filler, crospovidone EP Type A as desintegrant and magnesium stearate as lubricant, IMU-838 22.5 mg tablet, IMU-838 45 mg tablet

Primary endpoint: Intra-patient change in physical function as measured by the Short Form-36 Physical Function (SF-36-PF) from Baseline to Day 56
Endpoint(s): Intra-patient change in overall mental and physical health as measured by the SF-36-PF; from Baseline to Days 28, 56 and 84, Intra-patient change from Baseline to Days 28, 56 and 84 in a. Intensity of fatigue and incapacitation measured by the FSS b. Severity of mental disorder symptoms such as depression, anxiety, somatization, and distress measured by the PHQ modules PHQ-9, GAD-7, PHQ-15, and PHQ-stress, Intra-patient change from Baseline to Days 28 and 56 in Cognitive function measured by the MoCa, Intra-patient change from Baseline to Days 28, 56 and 84 in a. Severity of dyspnea, measured by the mMRC b. PEM frequency, strength and severity as measured by the PEM questionnaire c. Intra-patient change from Baseline to Days 28 and 56 in orthostatic/autonomic dysfunction measured by the PST d. Physical exercise capacity, measured as the change in number of repetitions during the 1MSTST, Intra-patient change from Baseline to Days 28 and 56 in a. Physical activity parameters: global activity (steps/24h), wear time (min), time spent in physical activity (min), resting (bpm) and activity heart rate bpm) b. Autonomic function parameters: heart rate turbulence, nocturnal heart rate, nocturnal respiratory rate, expiration-triggered sinus arrhythmia, baroreflex sensitivity, frequency of spontaneous ectopic beats measured by use of mhealth devices

Source: https://euclinicaltrials.eu/ctis-public/view/2024-511628-16-00